EU clinical trial 2024-518930-10-00: PYELOCOURT - 3-day intravenous antibiotic treatment versus 3-day intravenous followed by 7-day oral antibiotic treatment for acute pyelonephritis in children 1 month to 3 years old: a non-inferiority open randomized multicentric clinical trial
Protocol code: APHP211043
Sponsor: Assistance Publique Hopitaux De Paris (Hospital/Clinic/Other health care facility). Phase: Therapeutic confirmatory (Phase III). Countries: France (authorised, recruitment pending).
Therapeutic area(s): Diseases [C] - Bacterial Infections and Mycoses [C01]
Gender: Female, Male. Age: 0-17 years. Enrolment: 480.
Status: Authorised, recruitment pending. Decision date: 2024-11-26. Results received: No. Last updated: 2026-07-10.

Condition(s): acute pyelonephritis (AP) in children
Product: CEFIXIME, CEFTRIAXONE, AMIKACIN, SULFAMETHOXAZOLE AND TRIMETHOPRIM

Primary endpoint: The primary endpoint isrecurrence of febrile urinary tract infection within a 28 days period after the end completion of antibiotic treatment respectively at D31 (+/- 3 days) for the experimental group and D38 (+/- 3 days) for the control group.
Endpoint(s): Clinical cure 7 days after end of treatment, defined by apyrexia AND absence of signs suggestive of urinary infection (abdominal pain, urinary function signs) AND no feeding problem collected during a medical visit, respectively at D10 (+/- 3 days) for the experimental group and D17 (+/- 3 days) for the control group., Recurrent of AP within 90 days after the beginning of therapy (day 90 ± 15 days) collected during a phone call., Colonization with antimicrobial resistant Enterobacteriaceae in the gastrointestinal tract at days of randomization and at D10 (+/- 3 days) for the experimental group and D17 (+/- 3 days) for the control group, Alpha-diversity measured by Shannon’s index at inclusion, randomization, and at D10 (+/- 3 days) and D31 (+/- 3 days) for the experimental group, and D17 (+/- 3 days) and D38 (+/- 3 days) for the control group .

Source: https://euclinicaltrials.eu/ctis-public/view/2024-518930-10-00